EU clinical trial 2022-500318-24-00: Evaluation of quantitative sensory testing (QST) using subcutaneous administration of single escalating doses of halneuron® (tetrodotoxin (TTX)) for injection in healthy volunteers
Sponsor: Leiden University Medical Center (Hospital/Clinic/Other health care facility). Phase: Therapeutic exploratory (Phase II). Countries: Netherlands (ended).
Therapeutic area(s): Diseases [C] - Nervous System Diseases [C10]; Analytical, Diagnostic and Therapeutic Techniques and Equipment [E] - Anesthesia and Analgesia [E03]
Gender: Female, Male. Age: 18-64 years. Enrolment: 25.
Status: Ended. Start date (EU): 2023-08-30. End date (EU): 2024-02-26. Decision date: 2023-07-21. Results received: Yes. Last updated: 2023-08-18.

Condition(s): pain
Product: HALNEURON® (Tetrodotoxin for Injection)

Primary endpoint: The change from baseline in all individual QST sensory measurements at 1-hour post-dose for each dose administered.
Endpoint(s): To compare the change at 1-hour post-dose from baseline in the different QST sensory test measurements between the two doses administered., The change from baseline of the odor identification and odor threshold test at 1 hour post-dose for each dose administered., The change from baseline in the hypoxic ventilatory response at 1-hour post-dose for each dose administered., To compare adverse events reported to changes in QST measurements

Source: https://euclinicaltrials.eu/ctis-public/view/2022-500318-24-00